EU clinical trial 2025-520697-19-00: A randomized, double-blinded clinical trial comparing the efficacy of antibiotic or inhaled corticosteroid to placebo in children's protracted cough
Sponsor: Pirkanmaan hyvinvointialue (Hospital/Clinic/Other health care facility). Phase: Therapeutic confirmatory (Phase III). Countries: Finland (ongoing, recruiting).
Therapeutic area(s): Diseases [C] - Respiratory Tract Diseases [C08]
Gender: Female, Male. Age: 0-17 years. Enrolment: 160.
Status: Ongoing, recruiting. Start date (EU): 2025-10-20. Decision date: 2025-06-19. Results received: No. Last updated: 2026-02-26.

Condition(s): Protracted cough
Product: Flixotide Evohaler 125 mikrog/annos inhalaatiosumute, suspensio, Amorion Comp 80 mg/ml jauhe oraalisuspensiota varten, Evohaler- harjoitteluinhalaattori tilanjatkeella (ei sisällä vaikuttavaa ainetta), Syrspend oraaliliuos

Primary endpoint: Yskän merkittävä väheneminen (loppuminen tai vähintään 75 % oirepisteiden lasku lähtötilanteeseen verrattuna kolmena peräkkäisenä vuorokautena)

Source: https://euclinicaltrials.eu/ctis-public/view/2025-520697-19-00